EU clinical trial 2023-510110-36-00: A Phase 3, 52-week, open-label, single arm study to investigate the efficacy and safety of mepolizumab SC in participants aged 6 to 17 years with hypereosinophilic syndrome.
Protocol code: 215360
Sponsor: Glaxosmithkline Research & Development Limited (Pharmaceutical company). Phase: Therapeutic confirmatory (Phase III). Countries: Spain (ended), Netherlands (ended).
Therapeutic area(s): Diseases [C] - Hemic and Lymphatic Diseases [C15]
Gender: Female, Male. Age: 0-17 years. Enrolment: 7.
Status: Ended. Start date (EU): 2022-07-11. End date (EU): 2025-07-16. End date: 2025-10-28. Decision date: 2024-07-01. Results received: Yes. Last updated: 2025-07-29.
Decision dates by country: ES: 2024-07-04, NL: 2024-07-01

Condition(s): Hypereosinophilic syndrome (HES)
Product: MEPOLIZUMAB

Primary endpoint: Frequency of HES flares over the 52-week study treatment period
Endpoint(s): Change in the mean daily OCS dose (prednisone/prednisolone or equivalent) from Weeks 0 to 4 to Weeks 48 to 52, Reduction of ≥50% in mean daily OCS dose (prednisone/prednisolone or equivalent) from Weeks 0 to 4 compared with Weeks 48 to 52, Achieving a mean daily OCS dose (prednisone/prednisolone or equivalent) of ≤7.5 mg during Weeks 48 to 52, Change from baseline in fatigue severity based on weekly average score of BFI item 3 (worst level of fatigue during past 24 hours) for Week 52, Occurrence of ADA and NAb, Ratio to baseline in absolute blood eosinophil count at discrete time points during the 52-week study treatment period, Mepolizumab plasma concentration at discrete time points during the 52-week study treatment period

Source: https://euclinicaltrials.eu/ctis-public/view/2023-510110-36-00